EU clinical trial 2025-521371-31-00: PALETTE - Adaptive platform trial for personalisation of sepsis treatment in children and adults: a multi-national, treatable traits-guided, adaptive, exploratory, bayesian basket trial
Protocol code: APHP240923
Sponsor: Assistance Publique Hopitaux De Paris (Hospital/Clinic/Other health care facility). Phase: Therapeutic exploratory (Phase II). Countries: France (ongoing, recruiting).
Therapeutic area(s): Diseases [C] - Bacterial Infections and Mycoses [C01]; Diseases [C] - Virus Diseases [C02]
Gender: Female, Male. Age: 0-17 years, 18-64 years, 65+ years. Enrolment: 2000.
Status: Ongoing, recruiting. Start date (EU): 2026-07-09. Decision date: 2025-11-24. Results received: No. Last updated: 2026-05-13.

Condition(s): Sepsis
Product: INTERFERON GAMMA, TOCILIZUMAB, DALTEPARIN, HEPARIN, BARICITINIB, FLUDROCORTISONE, HYDROCORTISONE, OCTAPLASLG, solution pour perfusion, BARICITINIB, ANAKINRA, FILGRASTIM

Primary endpoint: Dual primary endpoints will be 1/ 28-day all-cause mortality 2/ Number of days alive without life-supportive therapies (respiratory support: high flow oxygen, non-invasive or invasive mechanical ventilation, extracorporeal membrane oxygenation or CO2 removal; cardiovascular support: continuous infusion of any dose of vasopressor or inotrope, or mechanical circulatory assistance; renal support: intermittent or continuous renal replacement therapy) at day 28 after randomization
Endpoint(s): Composite and hierarchised of the 2 dual primary outcomes, using a Generalized Pairwise Comparison (GPC) for Prioritized Outcomes,, 90-day, 1-year, and 3-year survival, 1- and 3-years hospital free days, Time to recover walking without aid, Time to resume previous social and professional activities, Quality of life at 90-day, 1-year, and 3-year using, in adults, SF-36, and 5-level EQ-5D version (EQ-5D-5L), and in children the Functional Status Scale (FSS) and the PedsQL.

Source: https://euclinicaltrials.eu/ctis-public/view/2025-521371-31-00